EU clinical trial 2024-511601-34-00: Post-Operative Atrial Fibrillation after Surgical Aortic Valve Replacement and the influence of HMG-CoA reductase inhibitors
Protocol code: STARC210421
Sponsor: Odense University Hospital (Hospital/Clinic/Other health care facility). Phase: Therapeutic use (Phase IV). Countries: Denmark (ongoing, recruiting).
Therapeutic area(s): Diseases [C] - Cardiovascular Diseases [C14]
Gender: Female, Male. Age: 18-64 years, 65+ years. Enrolment: 366.
Status: Ongoing, recruiting. Start date (EU): 2022-03-19. Decision date: 2024-03-21. Results received: No. Last updated: 2024-03-21.

Condition(s): Patients undergoing surgical aortic valve replacement.
Product: ATORVASTATIN, Lactose monohydrate 307,5mg, Patato starch 310,0mg, Gelatine 6,4mg, Magnesium stearate 3,25mg, Talc 29,25mg

Primary endpoint: 1. Number of Participants with POAF - In-hospital; 2. Number of Participants with POAF within 30 days. 3. Number of Participants with AFIB within 1 year.
Endpoint(s): 4) Rate of All-cause mortality 7) Myocardial injury - TnT 8) Myocardial injury - CKMB 9) Stroke - Early 10) Stroke - Intermediate 11) Trans ischemic attack 13) Myocardial infarction 15) Permanent pacemaker 17) ICD implantation 19) Acute kidney injury 21) Left ventricular ejection fraction 22) Strain 23) Peak gradient 24) Mean gradient 25) TAPSE 26) Length of stay on ICU 27) Length of stay in hospital

Source: https://euclinicaltrials.eu/ctis-public/view/2024-511601-34-00